EU clinical trial 2024-514617-35-00: P2-IMU-838-PMS - Multicenter, Randomized, Double-blind, Placebo-controlled Study to Evaluate Efficacy, Safety, and Tolerability of IMU-838 in Patients with Progressive Multiple Sclerosis (Calliper)
Protocol code: P2-IMU-838-PMS
Sponsor: Immunic AG (Pharmaceutical company). Phase: Therapeutic exploratory (Phase II). Countries: Germany (authorised, recruiting), Czechia (authorised, recruiting), Netherlands (authorised, recruiting), Bulgaria (authorised, recruiting), Romania (authorised, recruiting), Poland (authorised, recruiting).
Therapeutic area(s): Diseases [C] - Nervous System Diseases [C10]
Gender: Female, Male. Age: 18-64 years. Enrolment: 230.
Status: Authorised, recruiting. Start date (EU): 2021-12-20. Decision date: 2024-09-12. Results received: No. Last updated: 2026-05-04.
Decision dates by country: NL: 2024-09-18, PL: 2024-10-21, DE: 2024-09-17, BG: 2024-09-16, CZ: 2024-09-12, RO: 2024-09-25

Condition(s): Progressive forms of Multiple Sclerosis
Product: IMU-838 22.5 mg tablet, Placebo for IMU-838 Tablets, IMU-838 45 mg tablet

Primary endpoint: Annualized rate of percent brain volume change (PBVC) during MT period.
Endpoint(s): Time to 24-week confirmed disability worsening as assessed on a composite of EDSS, 9-Hole Peg Test (9-HPT), or Timed 25-foot Walk (T25-FW) (24wCDW-Comp) during the MT period

Source: https://euclinicaltrials.eu/ctis-public/view/2024-514617-35-00